EU clinical trial 2023-508350-26-00: Phase 3 Randomized, Placebo-Controlled Study to Assess Safety, Tolerability and Efficacy of Garetosmab in Patients with Fibrodysplasia Ossificans Progressiva
Protocol code: R2477-FOP-2175
Sponsor: Regeneron Pharmaceuticals Inc. (Pharmaceutical company). Phase: Therapeutic confirmatory (Phase III). Countries: Finland (ended), Italy (ended), Spain (ended), Netherlands (ongoing, recruitment ended), Poland (ongoing, recruitment ended), France (ongoing, recruitment ended).
Therapeutic area(s): Diseases [C] - Musculoskeletal Diseases [C05]
Gender: Female, Male. Age: 18-64 years, 65+ years. Enrolment: 24.
Start date (EU): 2023-03-02. Decision date: 2024-05-13. Results received: No. Last updated: 2026-05-21.
Decision dates by country: FR: 2024-05-15, FI: 2024-05-14, ES: 2024-05-13, PL: 2024-05-16, IT: 2024-05-20, NL: 2024-05-21

Condition(s): Fibrodysplasia Ossificans Progressiva
Product: Placebo matching to garetosmab, Garetosmab

Primary endpoint: Number of new HO lesions, Incidence and severity of treatment-emergent adverse events of special interest (AESIs)
Endpoint(s): Number of clinician-assessed flare-ups., Occurrence of new HO lesions, Total volume of new HO lesions, Occurrence of patient-reported flare-ups, Number of new HO lesions, Occurrence of clinician-assessed flare ups, Number of patient reported flare-ups, Change in joint function assessment by physician using cumulative analog joint involvement scale (CAJIS), Change in pulmonary function as assessed by spirometry, Change in disease severity as assessed by the Patient Global Impression of Severity (PGIS), Change in disease severity as assessed by the Patient’s Global Impression of Change (PGIC)., Change in disease severity as assessed by the Clinician’s Global Impression of Change (CGIC)., Concentration of total activin A in serum over time., Concentrations of garetosmab in serum over time., Incidence of anti-drug antibodies (ADA) to garetosmab over time., Titer of ADA to garetosmab over time.

Source: https://euclinicaltrials.eu/ctis-public/view/2023-508350-26-00